EU clinical trial 2024-518976-30-00: A phase 1 trial to evaluate the safety, tolerability, pharmacodynamics, pharmacokinetics, and immunogenicity of VIS171 in participants with autoimmune disease(s)
Protocol code: VIS171-103
Sponsor: Otsuka Pharmaceutical Development & Commercialization Inc. (Pharmaceutical company). Phase: Human Pharmacology (Phase I)- Other. Countries: Bulgaria (ended), Poland (ended), Romania (ongoing, recruitment ended), Spain (ongoing, recruitment ended).
Therapeutic area(s): Diseases [C] - Immune System Diseases [C20]
Gender: Female, Male. Age: 18-64 years, 65+ years. Enrolment: 21.
Start date (EU): 2025-07-02. Decision date: 2025-05-15. Results received: No. Last updated: 2026-03-31.
Decision dates by country: PL: 2025-06-23, RO: 2025-06-23, ES: 2025-06-23, BG: 2025-06-23

Condition(s): Systemic lupus erythematosus, Immune-mediated focal segmental glomerulosclerosis, Alopecia Areata

Source: https://euclinicaltrials.eu/ctis-public/view/2024-518976-30-00